EU clinical trial 2024-517314-15-00: IMPACT OF ANTI-TNF, VEDOLIZUMAB AND TOFACITINIB ON AORTIC STIFFNESS, CAROTID INTIMA-MEDIA THICKNESS AND CARDIOVASCULAR RISK OF PATIENTS WITH ULCERATIVE COLITIS
Protocol code: PI2020_843_0114
Sponsor: Centre Hospitalier Universitaire Amiens Picardie (Hospital/Clinic/Other health care facility). Phase: Phase III and phase IV (Integrated). Countries: France (authorised, recruitment pending).
Therapeutic area(s): Diseases [C] - Digestive System Diseases [C06]
Gender: Female, Male. Age: 18-64 years, 65+ years. Enrolment: 100.
Status: Authorised, recruitment pending. Decision date: 2024-09-10. Results received: No. Last updated: 2024-09-10.

Condition(s): ulcerative colitis
Product: AMGEVITA 40 mg solution for injection in pre-filled syringe, XELJANZ 5 mg film-coated tablets, Entyvio 300 mg powder for concentrate for solution for infusion, Inflectra 100 mg powder for concentrate for solution for infusion, Simponi 45 mg/0.45 mL solution for injection in pre-filled pen.

Primary endpoint: Carotid intima media thickness (CIMT)
Endpoint(s): Aortic pulse wave velocity (aPWV) / arterial stiffness, Augmentation index (AIx), Framingham score, the 10-year atherosclerotic CV disease risk (ASCVD) indices (reflect of the cardiovascular risk) and the SCORE score, Ulcerative colitis activity score /Mayo Score, Lipids parameters (HDL, LDL, TC, TG), Arterial tension and systolic pressure index, Endothelial function / Coagulation parameters

Source: https://euclinicaltrials.eu/ctis-public/view/2024-517314-15-00